EU clinical trial 2025-522775-29-00: A Phase 3, Randomized, Double-blind, Placebo-Controlled, Multicenter Study to Evaluate the Efficacy and Safety of Azetukalner in Depressive Episodes Associated With Bipolar I or II Disorder (Bipolar Depression)
Protocol code: XPF-010-B301
Sponsor: Xenon Pharmaceuticals Inc. (Pharmaceutical company). Phase: Therapeutic confirmatory (Phase III). Countries: Germany (authorised, recruiting), Bulgaria (ongoing, recruiting), Spain (authorised, recruiting), Poland (not authorised).
Therapeutic area(s): Psychiatry and Psychology [F] - Mental Disorders [F03]
Gender: Female, Male. Age: 18-64 years, 65+ years. Enrolment: 123.
Start date (EU): 2026-06-05. Decision date: 2026-03-10. Results received: No. Last updated: 2026-06-18.
Decision dates by country: BG: 2026-03-13, ES: 2026-03-13, PL: 2026-03-16, DE: 2026-03-10

Condition(s): Depressive episodes associated with Bipolar disorder I or II (Bipolar Depression)
Product: XPF-010, Placebo

Primary endpoint: Change from baseline in the MADRS total score at Week 6.
Endpoint(s): Change from baseline in the CGI-S score at Week 6., Change from baseline in the MADRS total score at Week 1., Change from baseline in the SHAPS total score at Week 6.

Source: https://euclinicaltrials.eu/ctis-public/view/2025-522775-29-00